EU clinical trial 2025-521139-35-01: Obinutuzumab induced decreases of PLA2Rab in MN: a pilot study
Protocol code: 2025-521139-35-01
Sponsor: Radboud universitair medisch centrum Stichting (Hospital/Clinic/Other health care facility). Phase: Therapeutic exploratory (Phase II). Countries: Netherlands (authorised, recruitment pending).
Therapeutic area(s): Diseases [C] - Immune System Diseases [C20]
Gender: Female, Male. Age: 18-64 years, 65+ years. Enrolment: 20.
Status: Authorised, recruitment pending. Decision date: 2025-07-31. Results received: No. Last updated: 2025-07-31.

Condition(s): Primary membranous nephropathy
Product: Gazyvaro 1,000 mg concentrate for solution for infusion.

Primary endpoint: Disappearance rate (half-life) of anti-PLA2R antibodies.
Endpoint(s): Immunological remission defined as IFT negative., Efficacy on clinical disease activity, defined as either CR or PR at 12 months., Adverse events., Quality of life during obinutuzumab treatment.

Source: https://euclinicaltrials.eu/ctis-public/view/2025-521139-35-01